EU clinical trial 2025-521179-29-00: Restarting Early versus Later Anticoagulation for Chronic Subdural Hematoma with Atrial Fibrillation (RELACS)
Protocol code: RELACS
Sponsor: HUS-Yhtymae (Hospital/Clinic/Other health care facility). Phase: Phase II and Phase III (Integrated). Countries: Finland (ongoing, recruiting), Sweden (ongoing, recruiting).
Therapeutic area(s): Diseases [C] - Nervous System Diseases [C10]; Diseases [C] - Cardiovascular Diseases [C14]
Gender: Female, Male. Age: 18-64 years, 65+ years. Enrolment: 332.
Status: Ongoing, recruiting. Start date (EU): 2025-07-06. Decision date: 2025-06-04. Results received: No. Last updated: 2025-06-05.
Decision dates by country: SE: 2025-06-05, FI: 2025-06-04

Condition(s): Chronic subdural hematoma, Atrial fibrillation
Product: EDOXABAN, APIXABAN, WARFARIN, DABIGATRAN ETEXILATE, RIVAROXABAN

Primary endpoint: Thromboembolic events (ischemic stroke, systemic embolism), Hemorrhagic events, Vascular death
Endpoint(s): All-cause mortality, modified Rankin Scale, Reoperation of ipsilateral hematoma, Number and type of unscheduled emergency radiological examinations, Number of emergency department visits, Postoperative total hospitalization days, counted from the day of surgery, Separation of the components of the primary outcome

Source: https://euclinicaltrials.eu/ctis-public/view/2025-521179-29-00